EU clinical trial 2023-505242-25-00: PHASE 2 DOSE-RANGING AND INTERCEPTION STUDY OF LINVOSELTAMAB IN PATIENTS WITH HIGH-RISK MONOCLONAL GAMMOPATHY OF UNDETERMINED SIGNIFICANCE OR NON-HIGH-RISK SMOLDERING MULTIPLE MYELOMA
Protocol code: R5458-ONC-2257
Sponsor: Regeneron Pharmaceuticals Inc. (Pharmaceutical company). Phase: Therapeutic exploratory (Phase II). Countries: Spain (ongoing, recruiting), Ireland (ongoing, recruiting), Belgium (ongoing, recruiting), France (ongoing, recruiting), Italy (ongoing, recruiting), Poland (ongoing, recruiting).
Therapeutic area(s): Diseases [C] - Neoplasms [C04]
Gender: Female, Male. Age: 18-64 years, 65+ years. Enrolment: 86.
Status: Ongoing, recruiting. Start date (EU): 2024-11-05. Decision date: 2024-05-20. Results received: No. Last updated: 2026-06-12.
Decision dates by country: PL: 2025-03-02, IE: 2024-05-24, BE: 2025-02-18, FR: 2025-02-27, IT: 2025-03-03, ES: 2024-05-20

Condition(s): High-Risk Monoclonal Gammopathy of Undetermined Significance; Non-High-Risk Smoldering Multiple Myeloma
Product: Diphenhydramine Hydrochloride 25 mg Tablets, Dexamethasone phosphate 4 mg/ml solution for injection/infusion, Paracetamol 500 mg Film-Coated Tablets, Linvoseltamab, RoActemra 20 mg/mL concentrate for solution for infusion, Dexamethasone 4 mg tablets

Primary endpoint: Part 1: Frequency of adverse events of special interest (AESI) during the safety observation period, Part 1: Frequency of treatment-emergent adverse events (TEAEs) during the safety observation period, Part 1: Severity of TEAEs during the safety observation period, Part 2: Achievement of complete response (CR) as determined by the investigator
Endpoint(s): Frequency of TEAEs, Severity of TEAEs, Frequency of serious adverse events (SAEs), Severity of SAEs, Frequency of laboratory abnormalities, Severity of laboratory abnormalities, Minimal residual disease (MRD) negativity among participants that achieve a response of CR, Sustained MRD negativity on an annual basis, Overall response of partial response (PR) or better as determined by the investigator, Duration of response (DOR) as determined by the investigator, Biochemical progression-free survival (PFS) as determined by the investigator, Concentration of linvoseltamab in serum over time, Incidence of anti-drug antibodies (ADAs) to linvoseltamab over the study duration, Magnitude of ADAs to linvoseltamab over the study duration

Source: https://euclinicaltrials.eu/ctis-public/view/2023-505242-25-00